EU clinical trial 2023-510391-31-00: The effect of different antibiotic protocols for dental implant surgery on peri-implant tissue health and on oral microbiome and resistome
Sponsor: Universita Degli Studi Di Genova (Educational Institution). Phase: Therapeutic use (Phase IV). Countries: Italy (ongoing, recruitment ended).
Therapeutic area(s): Diseases [C] - Stomatognathic Diseases [C07]
Gender: Female, Male. Age: 18-64 years. Enrolment: 80.
Status: Ongoing, recruitment ended. Start date (EU): 2024-05-02. Decision date: 2024-04-16. Results received: No. Last updated: 2024-06-27.

Condition(s): healthy patients
Product: ZIMOX 1 g compresse

Primary endpoint: Mean bone loss
Endpoint(s): - Incidence of biological and technical complications - Implant survival rate (CSR) - Antibiotic sensitivity 1 week before and 2-6 months after implant insertion - Peri-implant myco-, microbiome and resistome 1 week before and 2-6 months after implant insertion - Salivary miRNomics 1 week before and 2 months after implant insertion - Adverse reactions - Development of a 3D bone model (sub-study) - Plaque index (PI), Bleeding on probing (BOP) and probing depth (PPD) a at 3, 6 and 12 months

Source: https://euclinicaltrials.eu/ctis-public/view/2023-510391-31-00